EU clinical trial 2024-516327-14-00: A Randomized Clinical Trial Investigating Olaparib, Durvalumab (MEDI4736) and UV1 as Maintenance Therapy in BRCAwt Patients with Recurrent Ovarian Cancer.
Sponsor: Nordic Society Of Gynaecological Oncology Clinical Trial Unit (Patient organisation/association). Phase: Therapeutic exploratory (Phase II). Countries: Netherlands (ongoing, recruitment ended), Finland (ongoing, recruitment ended), Norway (ongoing, recruitment ended), Lithuania (ongoing, recruitment ended), Austria (ongoing, recruitment ended), Germany (ongoing, recruitment ended), Sweden (ongoing, recruitment ended), Belgium (ongoing, recruitment ended), Denmark (ongoing, recruitment ended).
Therapeutic area(s): Diseases [C] - Neoplasms [C04]
Gender: Female. Age: 18-64 years, 65+ years. Enrolment: 188.
Status: Ongoing, recruitment ended. Start date (EU): 2024-11-13. Decision date: 2024-11-13. Results received: No. Last updated: 2025-10-02.
Decision dates by country: LT: 2024-11-14, AT: 2024-11-19, FI: 2024-11-13, DK: 2024-11-15, DE: 2024-11-19, SE: 2024-11-15, NO: 2024-11-14, BE: 2024-11-19, NL: 2024-12-03

Condition(s): Ovarian cancer
Product: Leukine, Lynparza 100 mg film-coated tablets, IMFINZI 50 mg/mL concentrate for solution for infusion., Lynparza 150 mg film-coated tablets, UV1

Primary endpoint: Progression-free survival (PFS) arm A versus C.
Endpoint(s): PFS arm B versus arm C, Assessment of PROs, PFS assessed by blinded independent central review (BICR), Efficacy according to stratification factors, Efficacy according to PD-L1 status, Overall survival (OS), Time to first subsequent therapy (TFST), Subsequent progression (PFS2), Time to second subsequent therapy (TSST), Objective Response Rate (ORR), Disease Control Rate (DCR), Safety analysis., Exploratory endpoint: Evaluation of changes in genetic, molecular, and immunological markers of response and/or resistance over time., Exploratory endpoint: Correlation between changes in genetic, molecular, and immunological markers and efficacy in defined subgroups.

Source: https://euclinicaltrials.eu/ctis-public/view/2024-516327-14-00